EU clinical trial 2023-507717-94-00: A multicentre, intra-patient randomised controlled Phase III study to confirm the efficacy and safety of denovoSkin™, a bilayer engineered collagen-based skin graft composed of autologous fibroblasts and keratinocytes, for the treatment of patients with deep partial and full-thickness burns
Protocol code: dS-BA-PIII
Sponsor: Cutiss AG (Pharmaceutical company). Phase: Therapeutic confirmatory (Phase III). Countries: Netherlands (ongoing, recruiting), Italy (ongoing, recruiting), Belgium (ended), France (ongoing, recruiting), Portugal (ended), Poland (ongoing, recruiting), Spain (ongoing, recruiting), Germany (ongoing, recruiting).
Therapeutic area(s): Diseases [C] - Skin and Connective Tissue Diseases [C17]
Gender: Female, Male. Age: 0-17 years, 18-64 years, 65+ years. Enrolment: 98.
Start date (EU): 2024-12-06. Decision date: 2024-07-22. Results received: No. Last updated: 2026-08-03.
Decision dates by country: BE: 2024-07-29, PT: 2024-07-22, PL: 2024-07-29, IT: 2024-07-24, DE: 2024-07-26, ES: 2024-07-24, NL: 2024-07-22, FR: 2024-07-29

Condition(s): Deep partial and full-thickness burns
Product: EHSG-KF

Primary endpoint: A composite endpoint whereby success is defined by meeting both of the following criteria: • Wound closure defined as at least 95% epithelialisation at 10 weeks post-grafting • POSAS v2.0 overall opinion of at most 5, based on the observer evaluation (observer part of POSAS) at 6 months post-grafting
Endpoint(s): First Secondary Endpoints: • Ratio of covered surface area to biopsy site/donor site surface area at 4 weeks post-grafting • Limitation of scar contracture by assessing the size of the grafted areas at 6 months as compared to the grafting visit, Other Secondary Endpoints: • Epithelialisation percentage at 3 months and 6 months post-grafting • Graft take at 14 and 21 days post-grafting • Assessment of the donor sites (i.e., biopsies for IMP manufacturing and STSG grafting) at 4 and 10 weeks and 3, 6, 12, and 24 months post-grafting for: • Infection • Scar quality (patient and observer assessment using the POSAS v2.0 questionnaire), Other Secondary Endpoints: Assessment of the grafted burn wounds areas (i.e., experimental and control areas) at 4 and 10 weeks and 3, 6, 12, and 24 months post-grafting for: • Infection • Scar quality (patient and observer assessment using the POSAS v2.0 questionnaire). Note: Observer assessment using POSAS at 6 months is part of the composite primary endpoint., Other Secondary Endpoints: Limitation of scar contracture by assessing the size of the grafted areas at 12 and 24 months post-grafting

Source: https://euclinicaltrials.eu/ctis-public/view/2023-507717-94-00